EU clinical trial 2023-505515-21-00: TocilizuMab discontinuAtion in GIant Cell Arteritis
Protocol code: MAGICA
Sponsor: Centre Hospitalier Universitaire De Dijon (Hospital/Clinic/Other health care facility). Phase: Therapeutic confirmatory (Phase III). Countries: France (ongoing, recruitment ended).
Therapeutic area(s): Diseases [C] - Immune System Diseases [C20]
Gender: Female, Male. Age: 18-64 years, 65+ years. Enrolment: 120.
Status: Ongoing, recruitment ended. Start date (EU): 2024-04-02. Decision date: 2023-08-23. Results received: No. Last updated: 2026-04-27.

Condition(s): Giant Cell Arteritis
Product: RoActemra 162 mg solution for injection in pre-filled syringe., RoActemra 162 mg solution for injection in pre-filled pen.

Primary endpoint: Relapse-free survival in both groups (immediate vs. gradual discontinuation) at 26 weeks of follow-up, defined as the time from S0 (start of immediate/progressive discontinuation strategy) to relapse or death (any cause), whichever occurs first.
Endpoint(s): 1. Relapse-free survival in both groups (immediate vs. gradual discontinuation) at W52 and W78 - 2. Cumulative prednisone dose at W26, W52 and W78 - 3. Quality of life scores (HAQ, SF-36) at W0, W12, W26, W52 and W78 - 4. FACIT-Fatigue score at W0, W12, W26, W52 and W78 - 5. Percentage of patients in remission without prednisone at W26, W52 and W78 - 6. Percentage of patients in remission with prednisone dose ≤5 mg/day at W26, W52 and W78, Factors associated with relapse-free survival at 26, 52, 78 weeks of follow-up. Potential relapse factors will include all relevant variables such as demographic, clinical and biological data related to GCA (gender, age, large vessel involvement, CRP, fibrinogen, IL-6), duration of TCZ treatment before inclusion, relapse status before inclusion., Frequency and type of adverse events in both groups during the first 78 weeks after inclusion, Frequency of corticosteroid-related side effects (GTI score [Appendix 1] at baseline and at 52 weeks) in both groups, Immunomonitoring : a.Serum concentrations of haptoglobin, orosomucoid, CXCL10, IFN-γ, GM-CSF, IL-6, soluble IL-6R, and soluble gp130 measured by Luminex® at W0, W12, W26, and W52, and at relapse. - b. Percentage of Th1 (CD4+ IFN-γ+), Th17 (CD4+ IL-17+) and Treg (CD4+ CD25high FoxP3+) cells among total CD4+ T cells and expression levels of IL-6R and Gp130 by CD4+ T cells, measured by flow cytometry at W0, W12 and W26 and in case of relapse (limited to 5 centers: Dijon, Mâcon, Cochin, Metz, Nancy), Imaging: calculation of the vascular score (PETVAS50) measured by 18FDG PET scan to predict the risk of relapse at week 78. The PET scan will be performed between screening and randomization (centers able to perform the examination and send the anonymized images to Pr Jean-Louis Alberini [Georges François Leclerc Center, Dijon] for centralized review)

Source: https://euclinicaltrials.eu/ctis-public/view/2023-505515-21-00